EU clinical trial 2024-519639-40-00: A First-in-human Study to Evaluate the Safety and Anticancer Effect of Several Doses of TH9619 in Patients with Advanced Cancer (ODIN).
Protocol code: TH9619-0101
Sponsor: One-carbon Therapeutics AB (Pharmaceutical company). Phase: Human Pharmacology (Phase I)- First administration to humans. Countries: France (ongoing, recruiting), Spain (ongoing, recruiting).
Therapeutic area(s): Diseases [C] - Neoplasms [C04]
Gender: Female, Male. Age: 18-64 years, 65+ years. Enrolment: 33.
Status: Ongoing, recruiting. Start date (EU): 2025-08-18. Decision date: 2025-04-11. Results received: No. Last updated: 2026-05-14.
Decision dates by country: ES: 2025-04-11, FR: 2025-04-11

Condition(s): Solid tumors (including Non-Small Cell Lung Cancer (NSCLC), Colorectal Cancer (CRC), squamous cell carcinoma of the head and neck (HNSCC), and Gastric Cancer (GC))

Source: https://euclinicaltrials.eu/ctis-public/view/2024-519639-40-00